EU clinical trial 2026-525629-20-00: A Phase 1b-2, Open-Label, Dose-Escalation, Expansion and Optimization Study to Evaluate the Safety, Tolerability, Pharmacokinetics, Pharmacodynamics, and Preliminary Efficacy of LRK-4189 Alone and in Combination with mFOLFOX6 or FOLFIRI in Patients with Solid Tumors
Protocol code: LRK-4189-102
Sponsor: Larkspur Biosciences Inc. (Pharmaceutical company). Phase: Phase I and Phase II (Integrated)- Other. Countries: France (ongoing, recruiting).
Therapeutic area(s): Diseases [C] - Neoplasms [C04]
Gender: Female, Male. Age: 18-64 years, 65+ years. Enrolment: 80.
Status: Ongoing, recruiting. Start date (EU): 2026-07-30. Decision date: 2026-07-03. Results received: No. Last updated: 2026-07-03.

Condition(s): Solid tumors
Product: FLUOROURACIL, OXALIPLATIN, FOLINIC ACID, IRINOTECAN, FOLINIC ACID, LRK-4189, FLUOROURACIL

Primary endpoint: Part 1: Incidence, type and severity of adverse events (AEs) and serious AEs (SAEs), dose-limiting toxicity (DLT), treatment interruptions and discontinuations, by grade and attribution, safety labs and test results • PK parameters as below • If feasible, PD parameters as below • Shrinkage of target lesions, Part 2 : Per Response Evaluation Criteria in Solid Tumors (RECIST 1.1) [Eisenhauer 2009]: Objective response rate (ORR); Disease control rate (DCR), comprising ORR + stable disease (SD) (on at least 2 post-baseline timepoints > 4 weeks apart); Duration of response (DOR); Progression-free survival (PFS); Overall survival (OS), Part 3: Safety parameters as for Part 1; Efficacy parameters as for Part 2; PK parameters as for secondary endpoints; PD parameters as for exploratory endpoints
Endpoint(s): All that can be determined of: Time to maximum concentration (tmax);Terminal half-life (t½); Maximum observed concentration (Cmax);Area under the concentApparent volume of distribution at steady state (Vss/F);Mean residence time (MRT)ration-time curve from time zero to 24 hours and last detectable concentration (AUC0-24, AUClast); Area under the concentration-time curve from time zero extrapolated to infinity (AUC∞);Apparent total clearance (CL/F);Terminal elimination rate constant (λz);Appa, Safety parameters as Part 1, Safety parameters as Part 1;Efficacy parameters as Part 2;PK parameters as above, PD measurements in blood and/or tumor tissue for some or all of: Peripheral blood mononuclear cells (PBMCs): target degradation; PBMCs: immune cell frequency; PBMCs: activation state; Circulating tumor DNA (ctDNA); Bulk or single cell RNAseq or other nucleic acid testing; Whole exome sequencing of tumor; Serum for secreted protein (cytokine, chemokine) analysis ;Immunohistochemistry (IHC) for tumor and immune markers of PD including target degradation.

Source: https://euclinicaltrials.eu/ctis-public/view/2026-525629-20-00